EU clinical trial 2024-519979-26-00: Evaluation of patients with total coronary occlusions with multimodality image.
Protocol code: HCB.2021.1309
Sponsor: Fundacio De Recerca Clinic Barcelona-Institut D’Investigacions Biomediques August Pi I Sunyer (Laboratory/Research/Testing facility). Phase: Therapeutic use (Phase IV). Countries: Spain (authorised, recruitment pending).
Therapeutic area(s): Diseases [C] - Cardiovascular Diseases [C14]
Gender: Female, Male. Age: 18-64 years, 65+ years. Enrolment: 78.
Status: Authorised, recruitment pending. Decision date: 2025-01-10. Results received: No. Last updated: 2025-01-10.

Condition(s): Coronary artery chronic total occlusion
Product: Eufilina Venosa 200 mg solución inyectable, Clariscan 0,5 mmol/mL solución inyectable EFG, Rapiscan 400 microgram solution for injection

Primary endpoint: Viability: -Enhancement Criterion: mean late enhancement in more than 50% of the thickness of the affected myocardial wall using the 17-segment model. Number of segments meeting this criterion. -Myocardial Thickness Criterion: mean myocardial thickness less than 5 or 3 mm in segments with motility impairment. Number of segments meeting this criterion., Myocardial Ischemia: Inducible and persistent perfusion defect during the stress study that significantly improves or completely resolves in the rest study and exceeds the lateral or transmural extent of myocardial scar in the late enhancement study in the same myocardial segment. Number of segments with myocardial ischemia., Chronic Total Occlusion (CTO): Absence of antegrade coronary flow through the coronary stenosis. There may be flow through ipsilateral collaterals as long as there is no flow through the lesion. The CTO will be classified as definite if there is evidence of an occlusion lasting more than three months. If there is no evidence regarding the duration of the occlusion, it will be classified as probable.
Endpoint(s): Cardiac Magnetic Resonance Imaging (CMR): A baseline study will be performed and 6 months after the intervention according to routine clinical practice. All studies will be conducted on a 3T system (ARCHITECT GE)., Computed Tomography: A Computed Tomography study will be performed as part of routine clinical practice within the pre-procedural evaluation of percutaneous coronary revascularization. A protocol will be conducted that includes a static perfusion assessment at stress and rest, coronary angiography, and late enhancement for viability evaluation. A dual-source scanner with dual-energy capability (Somaton Flash Definition, SIEMENS) will be used., Adverse Events: The definitions provided by the Chronic Total Occlusion Academic Research Consortium (CTO-ARC) will be used., Arrhythmogenic Substrate: The evaluation of the arrhythmogenic substrate will be performed using late enhancement images obtained through a 3D Inversion-Recovery Gradient Echo sequence with free-breathing and respiratory navigator. The ADAS 3D software from Galgo Medical SL with CE marking will be used., Invasive Physiological Assessment: Invasive physiological assessment will be performed in all patients according to routine clinical practice with the aim of optimizing percutaneous treatment. Follow-up catheterization with invasive physiological assessment in patients with distal stenosis to the occlusion ≥ 50% will also be performed according to routine clinical practice (substudy of invasive coronary physiology).

Source: https://euclinicaltrials.eu/ctis-public/view/2024-519979-26-00